EU clinical trial 2024-520039-33-00: A Phase 2b, Randomized, Double-Blind, Placebo-Controlled Study to Evaluate the Efficacy and Safety of Tulisokibart in Participants with Moderate to Severe Hidradenitis Suppurativa
Protocol code: MK-7240-012
Sponsor: Merck Sharp & Dohme LLC (Pharmaceutical company). Phase: Phase II and Phase III (Integrated). Countries: Spain (ongoing, recruitment ended), France (ongoing, recruitment ended), Netherlands (ongoing, recruitment ended), Germany (ongoing, recruitment ended), Italy (ongoing, recruitment ended).
Therapeutic area(s): Diseases [C] - Skin and Connective Tissue Diseases [C17]
Gender: Female, Male. Age: 18-64 years, 65+ years. Enrolment: 46.
Status: Ongoing, recruitment ended. Start date (EU): 2025-08-11. Decision date: 2025-08-04. Results received: No. Last updated: 2026-07-31.
Decision dates by country: FR: 2025-08-04, IT: 2025-08-04, NL: 2025-08-05, ES: 2025-08-07, DE: 2025-08-07

Condition(s): Hidradenitis Suppurativa
Product: Placebo for MK-7240, tulisokibart

Primary endpoint: Percentage of Participants Achieving Hidradenitis Suppurativa Clinical Response (HiSCR)50 at Week 16
Endpoint(s): Percentage of Participants Achieving HiSCR75 at Week 16, Mean Change from Baseline in Dermatology Life Quality Index (DLQI) at Week 16, Percentage of Participants Who Experience One or More Adverse Events (AEs), Percentage of Participants Who Discontinue Study Intervention Due to an AE

Source: https://euclinicaltrials.eu/ctis-public/view/2024-520039-33-00